EU clinical trial 2022-501885-24-00: (21197) A multicenter, randomized, prospective double-blind, cross over Phase 3 study to evaluate the efficacy and safety of 0.04 mmol Gd/kg body weight of gadoquatrane for MRI in adults with known or suspected pathology of any body region (except CNS), compared to 0.1 mmol Gd/kg approved macrocyclic gadolinium-based contrast agents (GBCAs)
Protocol code: 21197
Sponsor: Bayer AG (Pharmaceutical company). Phase: Therapeutic confirmatory (Phase III). Countries: Czechia (ended), Sweden (ended), Italy (ended), France (ended), Bulgaria (ended), Poland (ended), Germany (ended), Hungary (ended).
Therapeutic area(s): Analytical, Diagnostic and Therapeutic Techniques and Equipment [E] - Diagnosis [E01]
Gender: Female, Male. Age: 18-64 years, 65+ years. Enrolment: 265.
Status: Ended. Start date (EU): 2023-09-20. End date (EU): 2024-12-20. End date: 2024-12-21. Decision date: 2023-08-22. Results received: Yes. Last updated: 2024-05-21.
Decision dates by country: BG: 2023-08-28, HU: 2023-09-01, IT: 2023-08-22, SE: 2023-08-22, FR: 2023-08-28, PL: 2023-08-28, CZ: 2023-08-23, DE: 2023-08-25

Condition(s): Contrast enhancement in magnetic resonance imaging for assessment of non-central nervous system pathology
Product: GADOTERIC ACID, GADOTERIDOL, GADOBUTROL, BAY 1747846

Primary endpoint: 3 visualization parameters (enhancement on a 4PS, delineation on a 4PS, morphology on a 3PS) assessed by separate blinded evaluation of combined pre- and post- gadoquatrane MRI and combined pre- and post-comparator MRI with macrocyclic GBCAs, by a BICR
Endpoint(s): Sensitivity and specificity for the detection of lesions of combined pre- and post-gadoquatrane MRI and combined pre- and post-comparator MRI with macrocyclic GBCAs, by a BICR, 3 visualization parameters (enhancement on a 4PS, delineation on a 4PS, morphology on a 3PS) assessed by separate blinded evaluation of unenhanced and combined pre- and post-gadoquatrane MRI, by a BICR, The overall diagnostic clinical value of combined pre- and post-gadoquatrane MRI and combined pre- and post-comparator MRI with macrocyclic GBCAs, based on i. the evaluation of diagnostic descriptive imaging features adapted from radiologic reporting standards (detection/exclusion of enhancing pathology; location, extent, and pattern of enhancement) on a 5PS (by BICR and Investigator); ii. the evaluation of patient management based on the diagnostic reporting recommendations (by Investigator), Sensitivity and specificity for the detection of malignant lesions of combined pre- and post-gadoquatrane MRI and combined pre- and post-contrastcomparator MRI with macrocyclic GBCAs assessed by BICR and the investigator, Describe the diagnoses from combined pre- and post- gadoquatrane MRI and combined pre- and post-comparator MRI with macrocyclic GBCAs by the Investigator, Confidence in diagnosis combined pre- and post-gadoquatrane MRI and combined pre- and post-comparator MRI with macrocyclic GBCAs by BICR and by Investigator on 4PS., Number of lesions seen on unenhanced MR image set and combined pre- and post-gadoquatrane MRI and combined pre- and post-comparator MRI with macrocyclic GBCAs, by a BICR, Number of enhancing lesions seen on combined pre- and post-gadoquatrane MRI and combined pre- and post-comparator MRI with macrocyclic GBCAs, by a BICR, Number and intensity of treatment emergent adverse events, including number of serious adverse events, after administration of gadoquatrane compared to macrocyclic GBCAs reported by the investigator during 24 ±4h p.i.

Source: https://euclinicaltrials.eu/ctis-public/view/2022-501885-24-00